EU clinical trial 2022-500538-27-00: A Phase 2/3, Multicenter, Randomized, Double blind, Placebo controlled Trial of the Safety and Efficacy of Flexible Doses of SEP 363856 as Adjunctive Therapy in the Treatment of Adults with Major Depressive Disorder.
Protocol code: 382-201-00001
Sponsor: Otsuka Pharmaceutical Development And Commercialization Inc. (Pharmaceutical company). Phase: Phase II and Phase III (Integrated). Countries: Czechia (ended), Bulgaria (ended), Spain (ended), Poland (ended), Hungary (ended), Germany (ended).
Therapeutic area(s): Diseases [C] - Nervous System Diseases [C10]
Gender: Female, Male. Age: 18-64 years, 65+ years. Enrolment: 256.
Status: Ended. Start date (EU): 2023-03-30. End date (EU): 2025-11-05. End date: 2025-11-13. Decision date: 2023-02-22. Results received: No. Last updated: 2025-12-18.
Decision dates by country: ES: 2023-02-22, DE: 2023-02-23, PL: 2023-02-27, BG: 2023-02-27, CZ: 2023-02-22, HU: 2023-02-23

Condition(s): Adjunctive therapy to antidepressants for the treatment of major depressive disorder (MDD) in adults.
Product: VENLAFAXINE, ESCITALOPRAM, Ulotaront, SERTRALINE, DULOXETINE, Ulotaront, FLUOXETINE, Ulotaront, SEP-363856 matching placebo, PAROXETINE

Primary endpoint: Change from the end of Phase A (Week 8 visit) to the end of Phase B (Week 14 visit) in the MADRS total score.
Endpoint(s): Standard safety variables to be examined in this trial will include AEs, physical examinations (including body weight and waist circumference), vital signs (blood pressure, heart rate, and body temperature), 12-lead ECGs, and clinical laboratory assessments (hematology, serum chemistry, urinalysis, prolactin, glycosylated hemoglobin, and coagulation parameters)., In addition to the standard safety variables, other safety variables including C-SSRS, SAS, AIMS, BARS, CSFQ, and PSQI will also be evaluated.

Source: https://euclinicaltrials.eu/ctis-public/view/2022-500538-27-00